EU clinical trial 2024-515972-11-00: A randomized, Phase I, single-center, observer-blind, active-controlled study to evaluate the safety, tolerability and immunogenicity of one single administration of PCV-LITE, a novel adjuvanted pneumococcal conjugate vaccine at one dose level of LiteVax Adjuvant, in healthy participants aged 18-50 years.
Protocol code: PCV-LITE-I
Sponsor: LiteVax B.V. (Pharmaceutical company). Phase: Human Pharmacology (Phase I)- First administration to humans. Countries: Belgium (authorised, recruitment pending).
Therapeutic area(s): Diseases [C] - Bacterial Infections and Mycoses [C01]
Gender: Female, Male. Age: 18-64 years. Enrolment: 80.
Status: Authorised, recruitment pending. Decision date: 2024-11-19. Results received: No. Last updated: 2024-11-19.

Condition(s): Pneumococcal infection

Source: https://euclinicaltrials.eu/ctis-public/view/2024-515972-11-00